EU clinical trial 2022-502010-85-00: An open-label, multicenter, Phase 1b/2a study to evaluate efficacy, safety, tolerability, and pharmacokinetics of the ATR inhibitor Tuvusertib (M1774) in combination with cemiplimab in participants with non-squamous non-small cell lung cancer that has progressed on prior anti-PD-(L)1 and platinum-based therapies (DDRiver NSCLC 322)
Protocol code: MS201924_0022
Sponsor: Merck Healthcare KGaA (Pharmaceutical company). Phase: Phase I and Phase II (Integrated)- Other. Countries: Spain (ended), Italy (ended), Belgium (ended), Germany (ended), France (ended).
Therapeutic area(s): Not possible to specify
Gender: Female, Male. Age: 18-64 years, 65+ years. Enrolment: 170.
Status: Ended. Start date (EU): 2023-12-20. End date (EU): 2026-07-15. End date: 2026-07-16. Decision date: 2023-11-28. Results received: No. Last updated: 2026-07-29.
Decision dates by country: FR: 2024-03-06, DE: 2023-11-28, BE: 2023-11-29, ES: 2023-11-29, IT: 2023-11-29

Condition(s): Non-Squamous Non-Small Cell Lung Cancer
Product: LIBTAYO 350 mg concentrate for solution for infusion., M1774, M1774, M1774

Primary endpoint: Phase 1b/Phase 2a: Confirmed Overall response (OR) According to Response Evaluation Criteria in Solid Tumor (RECIST) 1.1 As assessed by Investigator, Phase 1b: Number of Participants With Adverse Events (AEs) and Treatment- related AEs
Endpoint(s): Phase 1b/Phase 2a: Duration of Response (DoR) According to RECIST 1.1 as Assessed by the Investigator, Phase 1b/Phase 2a: Progression Free Survival (PFS) According to RECIST 1.1 as Assessed by the Investigator, Phase 1b/Phase 2a: Overall survival (OS), Phase 2a: Number of Participants With AEs and Treatment-related AEs

Source: https://euclinicaltrials.eu/ctis-public/view/2022-502010-85-00